EU clinical trial 2024-511660-89-00: Randomized, multicentre phase II trial of the sequencing of Radium-223 and Docetaxel plus prednisone in symptomatic bone-only metastatic castration-resistant prostate cancer (mCRPC)
Protocol code: IRST185.04
Sponsor: Istituto Romagnolo Per Lo Studio Dei Tumori Dino Amadori IRST S.r.l. (Hospital/Clinic/Other health care facility). Phase: Therapeutic exploratory (Phase II). Countries: Italy (ended).
Therapeutic area(s): Diseases [C] - Neoplasms [C04]
Gender: Male. Age: 18-64 years, 65+ years. Enrolment: 70.
Status: Ended. Start date (EU): 2017-06-09. End date (EU): 2026-02-26. Decision date: 2024-07-29. Results received: No. Last updated: 2025-06-06.

Condition(s): metastatic castration resistant prostate cancer (mCRPC), symptomatic bone-only metastatic castration resistant prostate cancer (mCRPC)
Product: Xofigo 1100 kBq/mL solution for injection, DELTACORTENE 5 mg compresse, Decadron “4 mg/1 ml Soluzione iniettabile”, Docetaxel Accord 20 mg/1 ml concentrate for solution for infusion, SOLDESAM 0,2% gocce orali, soluzione

Primary endpoint: HRQoL clinical benefit, according to the Functional Assessment of Cancer Therapy–Prostate (FACT-P) and Brief Pain Inventory-Short Form questionnaire (BPI) for bone pain intensity. We will perform HRQoL assessments at baseline, at every cycle of therapy, at EOT visit and during follow up both for Step 1 and 2, ARM A and B.
Endpoint(s): Progression-free survival (PFS), defined as the duration of time from randomization to time of progression or death, whichever occurred earlier, Total progression-free survival (TPFS), defined as total PFS at the end of the therapeutic sequence, Overall survival (OS), defined as the time from randomization to the date of death due to any cause or the last date the patient was known to be alive, Safety, Identification of markers predictive to clinical outcome including: translational studies of circulating tumor DNA and/or circulating tumor cells and/or circulating RNA and/or germ line DNA with the collection of blood samples: at C1D1 for Step 1 and 2 of both arms, before the cycle 4 for Step 1 ARM A and for Step 2 ARM B, before the cycle 5 for the Step 1 ARM B and Step 2 ARM A, at EOT visit and at 3 months of FUPfor Step 1 and 2 of both arms. As an option, it will be possible to require a sa, Identification of markers predictive to clinical outcome including: serum chromogranin A and neuron specific enolase levels at C1D1 for Step 1 and 2 of both arms, before the cycle 4 for Step 1 ARM A and for Step 2 ARM B, before the cycle 5 for the Step 1 ARM B and Step 2 ARM A, at EOT visit and at 3 months of FUP for Step 1 and 2 of both arms., Identification of markers predictive to clinical outcome including: PET with choline and/or new tracer (optional): at baseline (See paragraph 5.3), at 4 weeks (±2 weeks) after the C1D1, and at EOT for the Step 1.

Source: https://euclinicaltrials.eu/ctis-public/view/2024-511660-89-00